EU clinical trial 2023-503945-78-00: Randomized, double-blind, placebo-controlled study assessing the safety, tolerability, pharmacokinetics and pharmacodynamics of pitolisant after repeated oral ascending doses for 14 days, including the pitolisant effect on cardiac repolarization in healthy volunteers.
Protocol code: BF2.649/P22-08
Sponsor: Bioprojet Pharma (Pharmaceutical company). Phase: Human Pharmacology (Phase I)- Other. Countries: Belgium (ended).
Therapeutic area(s): Diseases [C] - Nervous System Diseases [C10]
Gender: Male. Age: 18-64 years. Enrolment: 75.
Status: Ended. Start date (EU): 2023-06-13. End date (EU): 2024-07-24. Decision date: 2023-06-13. Results received: No. Last updated: 2024-07-26.

Condition(s): Narcolepsy with cataplexy, Narcolepsy

Source: https://euclinicaltrials.eu/ctis-public/view/2023-503945-78-00